EU clinical trial 2023-508290-81-00: A Phase 3, Randomized, Double-Blind, Multicenter, Placebo-Controlled Study of Inebilizumab Efficacy and Safety in IgG4-Related Disease.
Protocol code: VIB0551.P3.S2
Sponsor: Horizon Therapeutics Ireland Designated Activity Company (Pharmaceutical company). Phase: Therapeutic confirmatory (Phase III). Countries: Netherlands (ended), Italy (ongoing, recruitment ended), Germany (ended), Poland (ongoing, recruitment ended), Spain (ongoing, recruitment ended), France (ongoing, recruitment ended).
Therapeutic area(s): Diseases [C] - Immune System Diseases [C20]
Gender: Female, Male. Age: 18-64 years, 65+ years. Enrolment: 90.
Start date (EU): 2020-12-18. Decision date: 2024-03-27. Results received: No. Last updated: 2026-04-28.
Decision dates by country: NL: 2024-03-27, DE: 2024-03-28, FR: 2024-03-28, IT: 2024-03-28, ES: 2024-04-01, PL: 2024-03-29

Condition(s): Immunoglobulin G4-related disease (IgG4-RD)
Product: INEBILIZUMAB, 10 mL (nominal) solution containing 20 mM histidine/histidine hydrochloride, 70 mM sodium chloride, 106 mM (4% [w/v]) trehalose dihydrate, and 0.01% (w/v) polysorbate 80

Primary endpoint: Time to disease flare, defined as the time in days from Day 1 (dosing) to the date of the first treated and AC-determined IgG4 RD flare within the 52-week RCP. The date of disease flare is defined as the date of initiation of any flare treatment (new or increased GC treatment, other immunotherapy, or interventional procedure) deemed necessary by the Investigator for the flare.
Endpoint(s): 1. Annualized flare rate for treated and AC-determined flares during the RCP., 2. The proportion of subjects achieving flare-free, treatment-free complete remission at Week 52, defined as the lack of evident disease activity at Week 52, no AC-determined flare during the RCP, and no treatment for flare or disease control except the required 8-week GC taper., 3. The proportion of subjects achieving flare-free, corticosteroid-free complete remission at Week 52, defined as the lack of evident disease activity at Week 52, no AC-determined flare during the RCP, and no corticosteroid treatment for flare or disease control except the required 8-week GC taper., 4. Time to initiation of first treatment (medication or procedure) for new or worsening disease activity by the Investigator within the RCP, regardless of AC determination of flare., 5. Annualized flare rate for AC-determined flares, whether or not treated, during the RCP., 6. Glucocorticoid use, calculated as the cumulative GC dose taken for the purpose of IgG4 RD disease control during the RCP., 7. Incidence of treatment emergent adverse events (TEAEs), serious TESAEs, and TEAEs of special interest (AESIs) during the 52-week RCP and during the OLP., 8. The incidence of ADAs directed against inebilizumab during the RCP.

Source: https://euclinicaltrials.eu/ctis-public/view/2023-508290-81-00